EU clinical trial 2025-523389-26-00: A Phase 3, Multi-regional, Open-label, Randomized Study of Tirabrutinib vs Rituximab and Temozolomide in Participants with Relapsed/Refractory Primary Central Nervous System Lymphoma
Protocol code: ONO-4059-17
Sponsor: Deciphera Pharmaceuticals Inc. (Pharmaceutical company). Phase: Therapeutic confirmatory (Phase III). Countries: Czechia (authorised, recruiting), Germany (authorised, recruitment pending), Italy (authorised, recruiting), Belgium (authorised, recruitment pending), Spain (authorised, recruiting), Poland (authorised, recruitment pending), Austria (authorised, recruitment pending), France (authorised, recruiting).
Therapeutic area(s): Diseases [C] - Nervous System Diseases [C10]
Gender: Female, Male. Age: 18-64 years, 65+ years. Enrolment: 74.
Start date (EU): 2026-07-20. Decision date: 2026-05-14. Results received: No. Last updated: 2026-07-31.
Decision dates by country: AT: 2026-05-25, BE: 2026-05-18, CZ: 2026-05-14, DE: 2026-05-18, IT: 2026-05-20, PL: 2026-05-25, ES: 2026-05-19, FR: 2026-05-19

Condition(s): Relapsed/refractory primary central nervous system lymphoma
Product: Temomedac 100 mg hard capsules, Temomedac 20 mg hard capsules, Tirabrutinib, Temomedac 5 mg hard capsules, Truxima 100 mg concentrate for solution for infusion, Truxima 500 mg concentrate for solution for infusion

Primary endpoint: PFS based on blinded Independent Review Committee (BIRC) assessment according to International Primary Central Nervous System Lymphoma Collaborative Group (IPCG) criteria, defined as time from randomization to progressive disease (PD) or death due to any cause, whichever occurs first.
Endpoint(s): ORR based on BIRC per IPCG criteria, defined as the percentage of participants with a best overall response of complete response (CR), unconfirmed complete response (CRu), or partial response (PR)., OS, defined as the time from randomization until death due to any cause., CRR, BOR, TTR, TTCR, DOR, and DFS by BIRC: CRR based on BIRC per IPCG criteria, defined as the percentage of participants with a best overall response of CR or CRu, BOR based on BIRC per IPCG criteria, defined as the best response from randomization to the date of PD or the date of initiation of subsequent anticancer therapy for PCNSL, whichever occurs first., TTR based on BIRC per IPCG criteria, defined as time between randomization and the date of first response of CR, CRu, or PR., TTCR based on BIRC per IPCG criteria, defined as the time between randomization and the date of first complete response (CR or CRu)., DOR based on BIRC per IPCG criteria, defined as the time between the date of first response (CR, CRu, or PR) and the date of the first PD or date of death due to any cause, whichever occurs first., DFS based on BIRC per IPCG criteria, defined as the time between the date of first complete response (CR or CRu) and the date of the first PD, or date of death due to any cause, whichever occurs first., Change from baseline in Corticosteroid dose

Source: https://euclinicaltrials.eu/ctis-public/view/2025-523389-26-00